EU clinical trial 2026-525809-13-00: Efficacy, Safety, and Patient Satisfaction of Patient-Controlled Remimazolam Sedation in Outpatient Colonoscopy: A randomized controlled trial.
Protocol code: HERLEV-PCS-2026-01
Sponsor: Region Hovedstaden (Hospital/Clinic/Other health care facility). Phase: Therapeutic use (Phase IV). Countries: Denmark (authorised, recruitment pending).
Therapeutic area(s): Diseases [C] - Digestive System Diseases [C06]
Gender: Female, Male. Age: 18-64 years, 65+ years. Enrolment: 1.
Status: Authorised, recruitment pending. Decision date: 2026-07-06. Results received: No. Last updated: 2026-07-06.

Condition(s): The trial will study sedation related to colonoscopy, therefore the trial is not concerned with the underlaying medical condition leading to the colonoscopy.
Product: MIDAZOLAM, ALFENTANIL, REMIMAZOLAM

Primary endpoint: Composit outcome consisting of four parameters: procedure succes, no moderate/severe adverse events, discharge whitout delay and high patient satisfaction

Source: https://euclinicaltrials.eu/ctis-public/view/2026-525809-13-00